EU clinical trial 2024-517411-73-00: Immunogenicity and safety of the 20-Valent pneumococcal conjugate vaccine (PCV-20) administered during an acute febrile illness in adults: a multicentre randomized non-inferiority trial: PREV-HOSPIT
Protocol code: 24CH249
Sponsor: Centre Hospitalier Universitaire De Saint Etienne (Hospital/Clinic/Other health care facility). Phase: Therapeutic use (Phase IV). Countries: France (ongoing, recruiting).
Therapeutic area(s): Diseases [C] - Respiratory Tract Diseases [C08]
Gender: Female, Male. Age: 18-64 years, 65+ years. Enrolment: 1160.
Status: Ongoing, recruiting. Start date (EU): 2025-11-12. Decision date: 2025-02-24. Results received: No. Last updated: 2025-07-16.

Condition(s): Patient with medium or high risk for pneumococcal invasive infection
Product: Prevenar 20 suspension for injection in pre-filled syringe Pneumococcal polysaccharide conjugate vaccine (20-valent, adsorbed)

Primary endpoint: Proportion of immune “good responders” to PCV-20 at 1 month after vaccination in both arms. Immune“Good responders” are defined by both of the following criteria : a seroconversion (a 2-fold increase in VT IgG after vaccination), for ≥10 vaccine serotypes (VT) among the 13 tested on 20 in ELISA,AND an immune protective response defined as ELISA IgG > 1,3 μg/mL in ≥ 10 out 13 VT tested in both arms in the month following vaccination., OR a seroconversion (a 4-fold increase in VT IgG after vaccination), for ≥10 vaccine serotypes (VT) among the 13 tested on 20 in ELISA, AND an immune protective response defined as ELISA IgG < 1,3 μg/mL in ≥ 10 out 13 VT tested in both arms in the month following vaccination.
Endpoint(s): Safety endpoints in both arms in the month following vaccination: Number, type and severity of adverse events Frequency of local reactions Frequency of systemic events related to the vaccination, Proportion of immune good responders serotype by serotype at one month post vaccination (ELISA 2-fold increase and ELISA IgG > 1,3μg/mL)., OPA IgG titers for serotype by serotype at one month post vaccination in both groups measured a posteriori among immune good responders, Proportion of the participants immune “good responders” to PCV-20 in both arms, at 1 year after vaccination. “Good responders” being defined above (primary end-point), Number of low respiratory tract infections events in both arms until one year after vaccination., Number of confirmed S.pneumoniae infections in both arms until one year after inclusion, Description of richness and diversity of gut microbioma before vaccination associated with people qualified as immune good responders in both arms, Fold change kinetics (transcriptomics) (before and at 24 hours after vaccination) of vaccine-induced gene signatures in peripheral blood mononuclear cells and serum cytokine levels at baseline and 24 hours after vaccination in both arms., Frequency of specific PCV-20 IFNg secreting CD4 or CD8 T cells in both arms at one month post vaccination (Only for CHU of St Etienne), Frequency of specific PCV-20 IFNg secreting CD4 or CD8 T cells in both arms at one year post vaccination (Only for CHU of St Etienne), Proportion of volunteers with salivary IgA (specific of pneumococcus) in both arms at one month post vaccination

Source: https://euclinicaltrials.eu/ctis-public/view/2024-517411-73-00